EU clinical trial 2024-512375-12-00: An Open-Label, Phase 1 Study of the CTPS1 Inhibitor STP938 in Adult Subjects with Advanced Solid Tumors, with a Safety Expansion in Advanced CTPS2 Null Ovarian Cancer
Protocol code: STP938-201
Sponsor: Step Pharma (Pharmaceutical company). Phase: Human Pharmacology (Phase I)- Other. Countries: Spain (authorised, recruitment pending), France (ongoing, recruiting).
Therapeutic area(s): Diseases [C] - Neoplasms [C04]
Gender: Female, Male. Age: 18-64 years, 65+ years. Enrolment: 25.
Start date (EU): 2025-04-18. Decision date: 2024-11-18. Results received: No. Last updated: 2026-07-31.
Decision dates by country: ES: 2024-11-18, FR: 2024-11-19

Condition(s): Solid tumors and ovarian cancer

Source: https://euclinicaltrials.eu/ctis-public/view/2024-512375-12-00